EU clinical trial 2023-503644-13-00: Topical tacrolimus for the amelioration of breast cancer-related lymphedema: a randomized, double-blind, placebo-controlled phase II/III trial
Sponsor: Odense University Hospital (Hospital/Clinic/Other health care facility). Phase: Therapeutic confirmatory (Phase III). Countries: Denmark (ongoing, recruitment ended).
Therapeutic area(s): Diseases [C] - Hemic and Lymphatic Diseases [C15]
Gender: Female. Age: 18-64 years, 65+ years. Enrolment: 80.
Status: Ongoing, recruitment ended. Start date (EU): 2024-09-09. Decision date: 2024-05-16. Results received: No. Last updated: 2026-03-10.

Condition(s): Breast cancer-related lymphedema
Product: PLACEBO, TACROLIMUS

Primary endpoint: Change in lymphedema volume
Endpoint(s): Health-related quality of life, Lymphatic flow and - function, Skin fibrosis, Excessive water in the limb (L-Dex score)

Source: https://euclinicaltrials.eu/ctis-public/view/2023-503644-13-00